EU clinical trial 2024-515106-30-00: A Phase I/II Double-blind, randomized, placebo-controlled trial to preserve residual insulin secretion in children with recent onset Type 1 diabetes by giving oral Verapamil
Protocol code: Veradiab-1
Sponsor: Linkopings Universitet (Educational Institution). Phase: Phase I and Phase II (Integrated)- Other. Countries: Sweden (ongoing, recruiting).
Therapeutic area(s): Diseases [C] - Hormonal diseases [C19]; Diseases [C] - Immune System Diseases [C20]
Gender: Female, Male. Age: 0-17 years. Enrolment: 36.
Status: Ongoing, recruiting. Start date (EU): 2025-08-06. Decision date: 2025-02-11. Results received: No. Last updated: 2025-02-11.

Condition(s): Type 1 diabetes
Product: Placebo capsules corresponding to Isoptin for oral administration, VERAPAMIL

Primary endpoint: The primary endpoint for part A - Frequency of AE and SAE during the study period (from start of treatment to 18 months)., The primary endpoint for part B - Change in C-peptide (AUCmean 0-120 min) during an MMTT from baseline to month 24.
Endpoint(s): The secondary endpoints for part A - Degree of metabolic control measured by HbA1c and TiT measured with Continuous Glucose Monitoring (CGM), The secondary endpoints for part A-Insulin requirement measured as Insulin dose per kg body weight and 24 hours after 12 and 24 months, The secondary endpoints for part A - Preservation of residual beta cell function (C-peptide) measured by MMTT, The secondary endpoints for part B -Change in fasting C-peptide value during MMTT from baseline to month 24, The secondary endpoints for part B - Change in C-peptide 90 minute value during MMTT from baseline to month 24, The secondary endpoints for part B-Proportion of patients with peak C-peptide > 0.20 nmol/l at month 24., The secondary endpoints for part B- Change in Hemoglobin A1c (HbA1c) between baseline and subsequent visits., The secondary endpoints for part B-Change in exogenous insulin dose per kg body weight and 24 hours between baseline and subsequent visits when insulin doses are collected., The secondary endpoints for part B-Frequency of Serious Adverse Events related to study treatment.

Source: https://euclinicaltrials.eu/ctis-public/view/2024-515106-30-00